EU clinical trial 2024-510753-10-00: A Phase 3, 52-Week, Multicenter, Randomized, Placebo-controlled, Double-blind Study to Assess the Efficacy, Safety, and Tolerability of Rocatinlimab in Adult Subjects With Prurigo Nodularis Who are Inadequately Controlled on Topical Therapies or Not Eligible for Topical Therapies
Protocol code: 20230053
Sponsor: Amgen Inc. (Pharmaceutical company). Phase: Therapeutic confirmatory (Phase III). Countries: Greece (ended), Hungary (ended), Romania (ended), Spain (ended), France (ended), Sweden (ended), Austria (ended), Latvia (ended), Finland (ended), Portugal (ended), Germany (ended), Poland (ended), Belgium (ended), Italy (ended), Netherlands (ended).
Therapeutic area(s): Diseases [C] - Skin and Connective Tissue Diseases [C17]
Gender: Female, Male. Age: 18-64 years, 65+ years. Enrolment: 176.
Status: Ended. Start date (EU): 2024-11-01. End date (EU): 2026-06-25. Decision date: 2024-10-11. Results received: No. Last updated: 2026-07-20.
Decision dates by country: BE: 2024-12-02, LV: 2024-10-17, RO: 2024-10-21, AT: 2024-10-14, DE: 2024-10-16, PT: 2024-10-11, HU: 2024-10-15, NL: 2024-10-21, GR: 2024-10-18, FI: 2024-10-14, IT: 2024-12-02, SE: 2024-10-14, ES: 2024-10-14, PL: 2024-10-21, FR: 2024-10-14

Condition(s): Prurigo Nodularis
Product: Rocatinlimab, Placebo for AMG 451

Primary endpoint: Achieving reduction from baseline in weekly average of daily itching score at specified time points.
Endpoint(s): Improvement in investigator assessment of PN lesions, Improvement in daily itching from baseline., Improvement in daily skin pain from baseline, Change in quality of life from baseline., Change in sleep disturbance from baseline, Treatment-emergent adverse events , adverse events of special interest, and serious adverse events

Source: https://euclinicaltrials.eu/ctis-public/view/2024-510753-10-00